EU clinical trial 2026-525569-30-00: A study to learn how a high-fat meal affects the way elinzanetant is taken up by the body in healthy women
Protocol code: 23053
Sponsor: Bayer AG (Pharmaceutical company). Phase: Human Pharmacology (Phase I)- Other. Countries: Germany (authorised, recruitment pending).
Therapeutic area(s): Diseases [C] - Hormonal diseases [C19]
Gender: Female. Age: 18-64 years, 65+ years. Enrolment: 30.
Status: Authorised, recruitment pending. Decision date: 2026-07-10. Results received: No. Last updated: 2026-07-10.

Condition(s): Vasomotor symptoms as a sex hormone-dependent disorder in women and men

Source: https://euclinicaltrials.eu/ctis-public/view/2026-525569-30-00